EU clinical trial 2023-509130-18-00: Impact of Intraoperative Arteriography with Indocyanine Green in Preserving the Parathyroid Glands During Total Thyroidectomy With or Without Central Cervical Lymph Node Dissection. A Multicenter Prospective Randomized Trial.
Protocol code: GUIARTE-HUB-2022
Sponsor: Bellvitge University Hospital (Hospital/Clinic/Other health care facility). Phase: Therapeutic confirmatory (Phase III). Countries: Spain (authorised, recruitment pending).
Therapeutic area(s): Diseases [C] - Hormonal diseases [C19]; Analytical,Diagnostic,Therapeutic Techniques and Equipment [E]-Surgical Procedures, Operative [E04]
Gender: Female, Male. Age: 18-64 years, 65+ years. Enrolment: 394.
Status: Authorised, recruitment pending. Decision date: 2024-01-24. Results received: No. Last updated: 2025-08-29.

Condition(s): Hypothyroidism
Product: INDOCYANINE GREEN

Primary endpoint: Number (percentage) of PG preserved with intraoperative ICG arteriography and the number (percentage) of preserved PG without it.
Endpoint(s): Preoperative calcium, total protein, vitamin D, and PTH serum levels, Number of well perfused GP in situ, GP score according to the black and white system, Surgery duration, Intraoperative PTH serum level, Serum PTH, calcium, and total protein levels at 24h after surgery, Serum PTH levels 1, 3, 6 and 12 months after surgery, Presence or absence of hypoparathyroidism during the one-year follow-up. Hypoparathyroidism is defined as undetectable or inappropriately low serum PTH levels in the context of hypocalcemia.

Source: https://euclinicaltrials.eu/ctis-public/view/2023-509130-18-00